EU clinical trial 2025-520473-40-00: A Multicentre, Parallel-group, Phase IIb, Randomised, Double blind, Placebo-controlled, 4-Arm, 24-Week Study to Evaluate the Efficacy and Safety of AZD6793 Tablets in Adult Participants with Moderate to Very Severe Chronic Obstructive Pulmonary Disease (PRESTO).
Protocol code: D7860C00006
Sponsor: AstraZeneca AB (Pharmaceutical company). Phase: Therapeutic exploratory (Phase II). Countries: Spain (ongoing, recruiting), Greece (ongoing, recruiting), Bulgaria (ongoing, recruiting), Germany (ongoing, recruiting), Denmark (ongoing, recruiting), Hungary (ongoing, recruiting), Italy (ongoing, recruiting), Poland (ongoing, recruiting).
Therapeutic area(s): Diseases [C] - Respiratory Tract Diseases [C08]
Gender: Female, Male. Age: 18-64 years, 65+ years. Enrolment: 314.
Status: Ongoing, recruiting. Start date (EU): 2025-09-29. Decision date: 2025-09-22. Results received: No. Last updated: 2025-12-14.
Decision dates by country: GR: 2025-09-25, PL: 2025-09-27, DE: 2025-09-24, DK: 2025-11-07, ES: 2025-09-24, BG: 2025-09-29, HU: 2025-09-26, IT: 2025-09-22

Condition(s): Moderate to Very Severe Chronic Obstructive Pulmonary Disease (COPD)
Product: AZD6793, AZD6793 Placebo, AZD6793, AZD6793

Primary endpoint: Annualised rate of moderate or severe COPD exacerbations
Endpoint(s): Time to first moderate or severe COPD exacerbation: *Annualised rate of COPD exacerbations associated with emergency room visits, urgent care visits, or hospitalizations. *Annualised rate of severe COPD exacerbations. A severe exacerbation is defined as an exacerbation resulting in hospitalization or death due to COPD., * Annualised rate of COPDCompEx events. * Time to first COPDCompEx event., * Change from baseline in pre-bronchodilator (BD) FEV1 at Week 12 and Week 24. * Change from baseline in post-BD FEV1 at Week 12 and Week 24.", Change from baseline over 24 weeks in each of the following: - - Breathlessness, Cough and Sputum Scale (BCSS) total score. - COPD Assessment Test (CAT) total score - St George's Respiratory Questionnaire (SGRQ) total and domain scores., AZD6793 plasma concentrations at specific timepoints., Safety and tolerability evaluations as assessed by AEs, SAEs, AESis (X-ray confirmed pneumonia, serious infections, herpes zoster infections, severe COVID-19 infections, haematology events [anaemia, neutropenia, thrombocytopaenia], skin and hair depigmentation events during skin examinations) vital signs, physical examinations, clinical laboratory assessments (clinical chemistry, male reproductive hormones, haematology, and urinalysis), and ECGs

Source: https://euclinicaltrials.eu/ctis-public/view/2025-520473-40-00